EU clinical trial 2024-514048-98-00: A Double-Blind, Randomized, Active-Controlled, Parallel-Group, Phase 3 Study to Compare Efficacy and Safety of CT-P51 and Keytruda in Combination with Platinum-Pemetrexed Chemotherapy in Patients with Previously Untreated Metastatic Non-Squamous Non-Small Cell Lung Cancer
Protocol code: CT-P51 3.1
Sponsor: Celltrion Inc. (Pharmaceutical company). Phase: Therapeutic confirmatory (Phase III). Countries: Romania (ended), Croatia (ended), Spain (ended), Greece (ended), Poland (ended), Lithuania (ended).
Therapeutic area(s): Diseases [C] - Neoplasms [C04]
Gender: Female, Male. Age: 18-64 years, 65+ years. Enrolment: 210.
Status: Ended. Start date (EU): 2025-01-30. End date (EU): 2026-07-14. Decision date: 2024-12-12. Results received: No. Last updated: 2025-04-22.
Decision dates by country: HR: 2024-12-16, LT: 2024-12-12, PL: 2024-12-16, RO: 2024-12-16, GR: 2024-12-12, ES: 2024-12-13

Condition(s): Previously Untreated Metastatic Non-Squamous Non-Small Cell Lung Cancer
Product: ALIMTA 500 mg powder for concentrate for solution for infusion, Cisplatin Hikma 1 mg/ml Konzentrat zur Herstellung einer Infusionslösung, Pemetrexed Fresenius Kabi 25 mg/ml concentrate for solution for infusion, Carboplatin Hikma 10 mg/ml Konzentrat zur Herstellung einer Infusionslösung, ALIMTA 500 mg powder for concentrate for solution for infusion, ALIMTA 500 mg powder for concentrate for solution for infusion, ALIMTA 500 mg powder for concentrate for solution for infusion, Pembrolizumab, KEYTRUDA 25 mg/mL concentrate for solution for infusion

Primary endpoint: ORR (CR + PR) based on the confirmed BOR by the end of Cycle 11 according to RECIST version 1.1 in the ITT set

Source: https://euclinicaltrials.eu/ctis-public/view/2024-514048-98-00